EU clinical trial 2025-523461-17-01: AN INTERVENTIONAL PHASE 3, DOUBLE-BLIND, RANDOMIZED STUDY TO EVALUATE EFFICACY AND SAFETY OF PF-08634404 IN COMBINATION WITH CHEMOTHERAPY VERSUS PEMBROLIZUMAB IN COMBINATION WITH CHEMOTHERAPY IN ADULT PARTICIPANTS WITH LOCALLY ADVANCED OR METASTATIC NON-SMALL CELL LUNG CANCER
Protocol code: C6461001
Sponsor: Pfizer Inc. (Pharmaceutical company). Phase: Therapeutic confirmatory (Phase III). Countries: France (ongoing, recruiting), Italy (ongoing, recruiting), Hungary (ongoing, recruiting), Greece (ongoing, recruiting), Czechia (ongoing, recruiting), Spain (ongoing, recruiting), Poland (authorised, recruitment pending), Germany (ongoing, recruiting).
Therapeutic area(s): Diseases [C] - Neoplasms [C04]
Gender: Female, Male. Age: 18-64 years, 65+ years. Enrolment: 387.
Start date (EU): 2026-06-01. Decision date: 2026-03-24. Results received: No. Last updated: 2026-04-01.
Decision dates by country: CZ: 2026-03-24, ES: 2026-03-25, PL: 2026-03-27, HU: 2026-03-27, FR: 2026-03-24, DE: 2026-03-30, IT: 2026-03-26, GR: 2026-04-01

Condition(s): LOCALLY ADVANCED OR METASTATIC NON-SMALL CELL LUNG CANCER
Product: PACLITAXEL, PF-08634404, SODIUM CHLORIDE, PACLITAXEL ALBUMIN-BOUND, PEMBROLIZUMAB, CARBOPLATIN, PEMETREXED

Primary endpoint: Overall survival, PFS using RECIST v1.1 as assessed by BICR
Endpoint(s): 1. Key - Confirmed ORR using RECIST v1.1 as assessed by BICR, 2. PFS using RECIST v1.1 as assessed by investigator; Confirmed ORR using RECIST v1.1 as assessed by investigator; DoR using RECIST v1.1 as assessed by BICR; DoR using RECIST v1.1 as assessed by investigator, 3. AEs as characterized by type, frequency, intensity as graded by NCI CTCAE version 5.0, timing, seriousness, and relationship to study intervention(s); Laboratory test abnormalities as characterized by type, frequency, severity (as graded by NCI CTCAE version 5.0) and timing., 4. Predose and postdose concentrations of PF-08634404., 5. Incidence of ADA against PF-08634404, 6. Change from baseline in the global health status/QoL, and Physical function scores on the EORTC QLQ-C30; Change from baseline in dyspnea, cough, and chest pain scores on the EORTC QLQ-LC13; Time to definitive deterioration in the global health status/QoL and physical function scores on the EORTC QLQ-C30; Time to definitive deterioration in dyspnea, cough, and chest pain scores on the EORTC QLQ-LC13

Source: https://euclinicaltrials.eu/ctis-public/view/2025-523461-17-01